EU clinical trial 2024-519617-56-00: Magnesiumsulphate for Postoperative Analgesia In the Newly delivered, The MAG-PAIN randomized controlled trial.
Sponsor: Region Halland (Hospital/Clinic/Other health care facility). Phase: Therapeutic exploratory (Phase II). Countries: Sweden (authorised, recruitment pending).
Therapeutic area(s): Analytical, Diagnostic and Therapeutic Techniques and Equipment [E] - Anesthesia and Analgesia [E03]
Gender: Female. Age: 18-64 years. Enrolment: 150.
Status: Authorised, recruitment pending. Decision date: 2025-03-17. Results received: No. Last updated: 2025-03-17.

Condition(s): Postoperative pain
Product: MAGNESIUM SULFATE

Primary endpoint: Acute postoperative pain within 6 hours
Endpoint(s): Acute postoperative pain after 14 days, in both rest and movement., Acute postoperative pain after 24 hours, in both rest and movement, Persistent postoperative pain after 3 months in both rest and movement., Early recovery after 24 hours, Early recovery after 14 days., Opioidconsumption. Total opioid dose in intravenous morphine milligram equivalents after 24 hours., Postoperative nausea and vomiting. Highest intensity after 24 hours., Self-evaluated quality of breastfeeding and fetal connection. Highest score between 0 and 10 is compared between groups after 24 hours., Self-evaluated quality of breastfeeding and fetal connection. Highest score between 0 and 10 is compared between groups after 14 days.

Source: https://euclinicaltrials.eu/ctis-public/view/2024-519617-56-00